EU clinical trial 2022-502476-23-00: A Phase 2 Study Evaluating INCB099280 in Participants With Advanced Cutaneous Squamous Cell Carcinoma
Protocol code: INCB 99280-212
Sponsor: Incyte Corp. (Pharmaceutical company). Phase: Therapeutic exploratory (Phase II). Countries: Spain (ended), Netherlands (not authorised), Finland (ended), Romania (ended), France (ended), Hungary (ended), Croatia (ended).
Therapeutic area(s): Diseases [C] - Neoplasms [C04]
Gender: Female, Male. Age: 18-64 years, 65+ years. Enrolment: 97.
Status: Ended. Start date (EU): 2023-10-25. End date (EU): 2026-03-25. Decision date: 2023-09-12. Results received: No. Last updated: 2026-01-16.
Decision dates by country: NL: 2023-09-13, ES: 2023-09-12, FI: 2023-09-15, RO: 2023-09-13, HU: 2023-09-15, HR: 2023-09-18, FR: 2023-09-13

Condition(s): Treatment of immunotherapy-naive patients with previously untreated or recurrent locally advanced or metastatic cSCC not amenable to curative surgery and/or radiotherapy
Product: INCB099280

Primary endpoint: Objective response, defined as having a best overall response of confirmed CR or PR by BICR per RECIST v1.1 or composite criteria for metastatic cSCC and per WHO criteria for locally advanced cSCC., Incidence of TEAEs, assessed by physical examinations, changes in vital signs and ECGs, and analysis of clinical laboratory samples., Incidence of TEAEs leading to dose interruption, dose reduction, or study drug discontinuation.
Endpoint(s): Disease control, defined as having a best overall response of confirmed CR or PR, or SD, after a minimum of 15 weeks following the initiation of study treatment by BICR per RECIST v1.1 or composite criteria for metastatic cSCC and WHO criteria for locally advanced cSCC., DOR, defined as the time from the earliest date of confirmed CR or PR to the earliest date of disease progression by BICR per RECIST v1.1 or composite criteria for metastatic cSCC and WHO criteria for locally advanced cSCC or death due to any cause if occurring sooner than progression., TTR, defined as the time from the date of first dose to the earliest date of confirmed CR or PR by BICR per RECIST v1.1 or composite criteria for metastatic cSCC and WHO criteria for locally advanced cSCC., PFS, defined as the time from the date of first dose to the earliest date of disease progression by BICR per RECIST v1.1 or composite criteria for metastatic cSCC and WHO criteria for locally advanced cSCC or death due to any cause if occurring sooner than progression., OS, defined as the time from the date of first dose to death due to any cause., INCB099280 concentration in plasma.

Source: https://euclinicaltrials.eu/ctis-public/view/2022-502476-23-00